EU clinical trial 2022-500400-22-00: A Phase III, Randomized, Open-label, Clinical Trial to Compare Pembrolizumab with Brentuximab Vedotin in Subjects with Relapsed or Refractory Classical Hodgkin Lymphoma
Protocol code: MK-3475-204
Sponsor: Merck Sharp & Dohme LLC (Pharmaceutical company). Phase: Therapeutic confirmatory (Phase III). Countries: Sweden (ended), Czechia (ended), Poland (ended), France (ended), Germany (ended), Italy (ended).
Therapeutic area(s): Diseases [C] - Neoplasms [C04]
Gender: Female, Male. Age: 18-64 years, 65+ years. Enrolment: 114.
Status: Ended. Start date (EU): 2016-06-23. End date (EU): 2025-12-17. End date: 2026-01-14. Decision date: 2022-11-11. Results received: No. Last updated: 2026-02-03.
Decision dates by country: PL: 2022-11-15, IT: 2022-11-15, DE: 2022-11-14, SE: 2022-11-11, CZ: 2022-11-15, FR: 2022-11-14

Condition(s): Hodgkin lymphoma
Product: ADCETRIS 50 mg powder for concentrate for solution for infusion, KEYTRUDA 25 mg/mL concentrate for solution for infusion

Primary endpoint: Progression-free Survival (PFS), Overall Survival (OS)
Endpoint(s): Objective Response Rate (ORR)

Source: https://euclinicaltrials.eu/ctis-public/view/2022-500400-22-00